EU clinical trial 2022-502739-20-00: C0251006 - A PHASE 3, MULTICENTER, DOUBLE-BLIND, RANDOMIZED, PLACEBO-CONTROLLED STUDY TO EVALUATE THE EFFICACY AND SAFETY OF PF-06823859 IN PARTICIPANTS WITH ACTIVE IDIOPATHIC INFLAMMATORY MYOPATHIES (INCLUDING PARTICIPANTS WITH ACTIVE DERMATOMYOSITIS OR POLYMYOSITIS)
Protocol code: C0251006
Sponsor: Pfizer Inc. (Pharmaceutical company). Phase: Therapeutic confirmatory (Phase III). Countries: Bulgaria (ongoing, recruiting), Sweden (ongoing, recruiting), Hungary (ongoing, recruiting), Poland (ongoing, recruiting), France (ongoing, recruiting), Belgium (ended), Germany (ongoing, recruiting), Slovakia (ongoing, recruiting), Spain (ongoing, recruiting), Italy (ongoing, recruiting).
Therapeutic area(s): Diseases [C] - Immune System Diseases [C20]
Gender: Female, Male. Age: 18-64 years, 65+ years. Enrolment: 79.
Start date (EU): 2023-11-16. Decision date: 2023-10-13. Results received: No. Last updated: 2026-05-05.
Decision dates by country: BE: 2023-10-16, HU: 2023-10-18, IT: 2023-10-17, PL: 2023-10-18, BG: 2023-10-18, DE: 2023-10-16, FR: 2023-10-13, ES: 2023-10-16, SE: 2023-10-18, SK: 2023-10-13

Condition(s): Active Idiopathic Inflammatory Myopathies (Including Dermatomyositis or Polymyositis)
Product: Dazukibart, HYDROXYCHLOROQUINE, METHYLPREDNISOLONE, BUDESONIDE, METHOTREXATE, TRIAMCINOLONE ACETONIDE, Placebo for PF-06823859 solution for injection, AZATHIOPRINE, HYDROCORTISONE, METHOTREXATE, Placebo for dazukibart 60mg/ml solution for injection, BETAMETHASONE, PREDNISONE, DEFLAZACORT, PREDNISOLONE, METHYLPREDNISOLONE, CHLOROQUINE, MYCOPHENOLATE MOFETIL, LEFLUNOMIDE, PF-06823859, DEXAMETHASONE, BETAMETHASONE

Primary endpoint: Cohort 1 (DM) - Global (except US): Moderate improvement in TIS at Week 24; Cohort 2 (PM) - Global (except US): Moderate improvement in TIS at Week 24
Endpoint(s): Cohort 1 (DM): Global (except US) Change from baseline in MMT-8 score at Week 24. Change from baseline in Cutaneous Dermatomyositis Disease Area and Severity Index Activity Score (CDASI-A) at Week 24 for participants with baseline CDASI-A score ≥14. Normalized area under the dose-time curve (AUC) of corticosteroid dose over 52 weeks. Moderate improvement in TIS at Week 52., Cohort 1 (DM): Global (except US): Change from baseline in PROMIS-PF at week 24. Change from baseline in 5-D Itch Scale Score at Week 24 for participants with baseline CDASI-A score ≥14. • Change from baseline in FACIT-F score at Week 24., Cohort 2 (PM): Global (except US) Change from baseline in MMT-8 score at Week 24. Normalized AUC of corticosteroid dose over 52 weeks. Moderate improvement in TIS at Week 52. Change from baseline in PROMIS-PF at Week 24. Change from baseline in FACIT-F score at Week 24.

Source: https://euclinicaltrials.eu/ctis-public/view/2022-502739-20-00